EU clinical trial 2024-510746-14-00: Detailed assessment of axial and peripheral entheses and joints in axial spondyloarthritis and psoriatic arthritis patients treated with ixekizumab – a 2-year study applying whole-body MRI, MRI-based synthetic CT, and CT
Sponsor: Rigshospitalet (Hospital/Clinic/Other health care facility). Phase: Therapeutic use (Phase IV). Countries: Denmark (ongoing, recruiting).
Therapeutic area(s): Diseases [C] - Musculoskeletal Diseases [C05]
Gender: Female, Male. Age: 18-64 years, 65+ years. Enrolment: 65.
Status: Ongoing, recruiting. Start date (EU): 2024-08-28. Decision date: 2024-04-05. Results received: No. Last updated: 2026-02-19.

Condition(s): Axial Spondyloarthritis, Psoriatic Arthritis
Product: Taltz 80 mg solution for injection in pre-filled syringe

Primary endpoint: Change from baseline to month 12 in total inflammatory burden in the entire body (peripheral and axial joints and entheses), as assessed by WB-MRI, in patients with axSpA and PsA treated with IXE

Source: https://euclinicaltrials.eu/ctis-public/view/2024-510746-14-00